EU clinical trial 2024-516635-27-00: A Phase 3a, Observer-blind, Randomized, Controlled, Study to Evaluate the Immunogenicity and Safety of an Investigational Varicella Vaccine Compared with Varivax, When Given as a Second Dose to Healthy Children, 3 Months after the Administration of a First Dose at 12 to 15 Months of age
Protocol code: 214002 (VNS 20-004)
Sponsor: GlaxoSmithKline Biologicals (Pharmaceutical company). Phase: Therapeutic confirmatory (Phase III). Countries: Denmark (not authorised), Norway (not authorised).
Therapeutic area(s): Diseases [C] - Virus Diseases [C02]
Gender: Female, Male. Age: 0-17 years. Enrolment: 79.
Status: Not authorised. Decision date: 2025-06-03. Results received: No. Last updated: 2025-06-04.
Decision dates by country: DK: 2025-06-03, NO: 2025-06-04

Condition(s): Varicella
Product: VARIVAX® Pulver und Lösungsmittel zur Herstellung einer Injektionssuspension in einer Fertigspritze Varizellen-Lebendimpfstoff, VARIVAX® Pulver und Lösungsmittel zur Herstellung einer Injektionssuspension in einer Fertigspritze Varizellen-Lebendimpfstoff

Primary endpoint: Percentage of participants with seroresponse to Varicella Zoster Virus (VZV) antiglycoprotein E (gE) IgG for 2 doses of VNS vaccine compared to 2 doses of VV. Time frame: At Day 133 (43 days post-dose 2), Geometric Mean Concentration (GMC) of anti-VZV gE IgG for 2 doses of VNS vaccine compared to 2 doses of VV Time frame: At Day 133 (43 days post-dose 2)
Endpoint(s): Percentage of participants with seroresponse to anti-VZV gE IgG for VV-VNS group. Time frame: At Day 133 (43 days post-dose 2), GMC of anti-VZV gE IgG for VV-VNS group. Time frame: At Day 133 (43 days post-dose 2), Percentage of participants reporting each solicited administration site event. Time frame: Day 1 (post-dose 1) to Day 4, Percentage of participants reporting each solicited administration site event. Time frame: Day 91 (Day 1 post-dose 2) to Day 94, Percentage of participants reporting each solicited systemic event. Time frame: Day 1 (post-dose 1) to Day 15, Percentage of participants reporting each solicited systemic event. Time frame: Day 91 (Day 1 post-dose 2) to Day 105, Percentage of participants reporting each solicited systemic event in terms of fever. Time frame: Day 1 (post-dose 1) to Day 22, Percentage of participants reporting each solicited systemic event in terms of fever. Time frame: Day 91 (Day 1 post-dose 2) to Day 112, Percentage of participants reporting each solicited administration site event. Time frame: Day 1 (post-dose 1) to Day 43, Percentage of participants reporting each solicited administration site event. Time frame: Day 91 (Day 1 post-dose 2) to Day 133, Percentage of participants reporting each solicited systemic event. Time frame: Day 1 (post-dose 1) to Day 43, Percentage of participants reporting each solicited systemic event. Time frame: Day 91 (Day 1 post-dose 2) to Day 133, Percentage of participants reporting unsolicited adverse events (AEs). Time frame: Day 1 (post-dose 1) to Day 43, Percentage of participants reporting unsolicited adverse events (AEs). Time frame: Day 91 (Day 1 post-dose 2) to Day 133, Percentage of participants reporting medically attended AEs (MAAE). Time frame: Day 1 (post-dose 1) to Day 271 (study end), Percentage of participants reporting serious adverse events (SAEs). Time frame: Day 1 (post-dose 1) to Day 271 (study end)

Source: https://euclinicaltrials.eu/ctis-public/view/2024-516635-27-00